EU clinical trial 2024-516251-40-01: Multi-Center, Placebo-Controlled, Phase 3 Study of Etripamil Nasal Spray (NS) in Patients with Atrial Fibrillation and Rapid Ventricular Rate (RVR). The ReVeRA-301 Trial.
Protocol code: MSP-2017-5002
Sponsor: Milestone Pharmaceuticals Inc. (Pharmaceutical company). Phase: Therapeutic confirmatory (Phase III). Countries: Netherlands (authorised, recruitment pending).
Therapeutic area(s): Diseases [C] - Cardiovascular Diseases [C14]
Gender: Female, Male. Age: 18-64 years, 65+ years. Enrolment: 200.
Status: Authorised, recruitment pending. Decision date: 2026-07-27. Results received: No. Last updated: 2026-07-27.

Condition(s): Atrial Fibrillation
Product: Etripamil, Placebo for etripamil nasal spray

Primary endpoint: The maximum reduction in ventricular rate, measured from ECG CMS recordings, within 30 minutes from first drug administration.
Endpoint(s): Key Secondary Efficacy Variable: Improvement in participant symptoms as measured by a 7-unit anchored Likert scale as measured by ePRO administered 30 minutes after first study drug administration., Safety Endpoint: Safety variables will include clinical Adverse Events, vital signs, and findings from ECG CMS recordings., Additional secondary efficacy variables will include the following analyses: i) The key secondary efficacy variable (improvement in participant symptoms) as measured by ePRO administered 45 minutes after first study drug administration; ii) Participant satisfaction with how medication relieves their symptoms, as measured by ePRO administered 30 and 45 minutes after first study drug administration;, Additional secondary efficacy variables will include the following analyses: iii) A comparison of the change in HR from baseline to 30 minutes; iv) A comparison of the proportion of participants who achieve: ≥10% reduction in HR, ≥20% reduction in HR, ≥20 bpm reduction in HR, <100 bpm HR at 30 minutes, analyzed using chi-square test;, Additional secondary efficacy variables will include the following analyses: v) A comparison of the proportion of participants seeking medical interventions; vi) A comparison of the proportion of participants converting to SR, and the TTC after taking study drug;, Additional secondary efficacy variables will include the following analyses: vii) A comparison of the time to achieve defined HR reductions; viii) A repeat of the primary and selected secondary estimator analyses at additional timepoints/observation windows including 15, 45, 60, 90, 120, 150, 180, 240, and 300 minutes.

Source: https://euclinicaltrials.eu/ctis-public/view/2024-516251-40-01